EU clinical trial 2022-501483-18-00: A Randomized, Double-Blind Phase 2/3 Study of Fianlimab (Anti-LAG-3 antibody) in Combination with Cemiplimab (Anti-PD-1 antibody) versus Cemiplimab Monotherapy in First-Line Treatment of Patients with Advanced Non-Small Cell Lung Cancer (NSCLC) with Tumors Expressing PD-L1 ≥50%
Protocol code: R3767-ONC-2235
Sponsor: Regeneron Pharmaceuticals Inc. (Pharmaceutical company). Phase: Phase II and Phase III (Integrated). Countries: France (ended), Spain (ongoing, recruitment ended), Greece (ended), Romania (ended).
Therapeutic area(s): Diseases [C] - Neoplasms [C04]
Gender: Female, Male. Age: 18-64 years, 65+ years. Enrolment: 102.
Start date (EU): 2025-03-28. Decision date: 2024-05-20. Results received: No. Last updated: 2026-04-24.
Decision dates by country: ES: 2024-05-20, RO: 2024-10-28, GR: 2024-10-22, FR: 2024-05-22

Condition(s): Advanced Non-Small Cell Lung Cancer
Product: Fianlimab, LIBTAYO 350 mg concentrate for solution for infusion., Placebo for Fianlimab

Primary endpoint: Objective response rate (ORR) as assessed by blinded independent central review (BICR), using Response Evaluation Criteria in Solid Tumors version 1.1 (RECIST 1.1) (Phase 2), Overall survival (OS) (Phase 3)
Endpoint(s): Incidence of treatment-emergent adverse events (TEAEs) (Phase 2 and Phase 3), Incidence of treatment-related TEAEs (Phase 2 and Phase 3), Incidence of serious adverse events (SAEs) (Phase 2 and Phase 3), Incidence of adverse events of special interest (AESIs) (Phase 2 and Phase 3), Incidence of immune-mediated adverse events (imAEs) (Phase 2 and Phase 3), Occurrence of interruption of study drug(s) due to TEAEs (Phase 2 and Phase 3), Occurrence of discontinuation of study drug(s) due to TEAEs (Phase 2 and Phase 3), Occurrence of interruption of study drug(s) due to AESIs (Phase 2 and Phase 3), Occurrence of discontinuation of study drug(s) due to AESIs (Phase 2 and Phase 3), Occurrence of interruption of study drug(s) due to imAEs (Phase 2 and Phase 3), Occurrence of discontinuation of study drug(s) due to imAEs (Phase 2 and Phase 3), Incidence of deaths due to TEAE (Phase 2 and Phase 3), Incidence of grade 3 to 4 laboratory abnormalities (Phase 2 and Phase 3), ORR by investigator assessment, using RECIST 1.1 (Phase 2), Disease control rate (DCR) by BICR (Phase 2 and Phase 3), DCR by investigator assessment (Phase 2 and Phase 3), Time to tumor response (TTR) by BICR (Phase 2 and Phase 3), TTR by investigator assessment (Phase 2 and Phase 3), Duration of response (DOR) by BICR (Phase 2 and Phase 3), DOR by investigator assessment (Phase 2 and Phase 3), Progression free survival (PFS) by BICR (Phase 2 and Phase 3), PFS by investigator assessment (Phase 2 and Phase 3), Overall survival (OS) (Phase 2), Change from baseline in patient-reported Global health status/QoL per European Organization for Research and Treatment of Cancer Quality of Life Core Questionnaire (EORTC QLQ C30) (Phase 2 and Phase 3), Change from baseline in patient-reported physical functioning per EORTC QLQ C30 (Phase 2 and Phase 3), Change from baseline in patient-reported chest pain per European Organization for Research and Treatment of Cancer Quality of Life Questionnaire Lung Cancer (EORTC QLQ-LC13) (Phase 2 and Phase 3), Change from baseline in patient-reported dyspnea per EORTC QLQ-LC13 (Phase 2 and Phase 3), Change from baseline in patient-reported cough per EORTC QLQ-LC13 (Phase 2 and Phase 3), Time until definitive deterioration in patient-reported global health status/QoL per EORTC QLQ-C30 (Phase 2 and Phase 3), Time until definitive deterioration in patient-reported physical functioning per EORTC QLQ-C30 (Phase 2 and Phase 3), Time until definitive deterioration in patient-reported chest pain per EORTC QLQ-LC13 (Phase 2 and Phase 3), Time until definitive deterioration in patient-reported dyspnea per EORTC QLQ-LC13 (Phase 2 and Phase 3), Time until definitive deterioration in patient-reported cough per EORTC QLQ-LC13 (Phase 2 and Phase 3), Time until definitive deterioration in patient-reported composite of chest pain, dyspnea and cough per EORTC QLQ-LC13 (Phase 2 and Phase 3), Change from baseline in patient-reported general health status per EuroQoL-5 Dimensions, 5-level Questionnaire-Visual Analogue Score (EQ-5D-5L VAS) (Phase 2 and Phase 3), Change from baseline in patient-reported severity with usual or daily activities due to fatigue per the Patient Reported Outcomes for Common Terminology Criteria for Adverse Events (PRO-CTCAE). (Phase 2 and Phase 3), Change from baseline in patient-reported interference with usual or daily activities due to fatigue per the Patient Reported Outcomes for Common Terminology Criteria for Adverse Events (PRO-CTCAE). (Phase 2 and Phase 3), Concentrations of cemiplimab in serum (Phase 2 and Phase 3), Concentrations of fianlimab in serum (Phase 2 and Phase 3), Immunogenicity, as measured by anti-drug antibodies (ADA) to fianlimab (Phase 2 and Phase 3), Immunogenicity, as measured by ADA to cemiplimab (Phase 2 and Phase 3), Immunogenicity, as measured by neutralizing antibodies (NAb) to fianlimab (Phase 2 and Phase 3), Immunogenicity, as measured by NAb to cemiplimab (Phase 2 and Phase 3)

Source: https://euclinicaltrials.eu/ctis-public/view/2022-501483-18-00